EU clinical trial 2024-514520-16-00: A Randomized, Double-Blind, Placebo Controlled, Multi - Center, Phase 1b Study to Evaluate the Safety and Tolerability of LIV001 in Patients with Mild-to-Moderate Active Ulcerative Colitis
Protocol code: LIV001-02
Sponsor: Medytox Inc. (Pharmaceutical company). Phase: Human Pharmacology (Phase I)- Other. Countries: Poland (authorised, recruitment pending).
Therapeutic area(s): Diseases [C] - Digestive System Diseases [C06]
Gender: Female, Male. Age: 18-64 years. Enrolment: 8.
Status: Authorised, recruitment pending. Decision date: 2024-11-18. Results received: No. Last updated: 2026-06-12.

Condition(s): mild-to-moderate active ulcerative colitis

Source: https://euclinicaltrials.eu/ctis-public/view/2024-514520-16-00